EU clinical trial 2025-522019-40-00: A multi-center, open-label, phase I/II study to evaluate the safety and efficacy of asciminib with chemotherapy followed by blinatumomab in pediatric, adolescent, and young adult patients with relapsed or refractory BCR::ABL1-positive (Ph+) or ABL-class Ph-like Acute Lymphoblastic Leukemia (ALL)
Protocol code: CABL001L12101
Sponsor: Novartis Pharma AG (Pharmaceutical company). Phase: Phase I and Phase II (Integrated)- Other. Countries: Italy (authorised, recruitment pending), Spain (authorised, recruitment pending), Germany (authorised, recruitment pending), Netherlands (authorised, recruitment pending), France (authorised, recruitment pending), Denmark (authorised, recruitment pending), Czechia (authorised, recruitment pending).
Therapeutic area(s): Diseases [C] - Neoplasms [C04]
Gender: Female, Male. Age: 0-17 years, 18-64 years. Enrolment: 21.
Status: Authorised, recruitment pending. Decision date: 2026-04-27. Results received: No. Last updated: 2026-06-26.
Decision dates by country: CZ: 2026-04-28, DK: 2026-04-27, FR: 2026-04-28, DE: 2026-04-30, IT: 2026-06-26, ES: 2026-05-04, NL: 2026-04-29

Condition(s): relapsed or refractory BCR::ABL1-positive (Philadelphia positive, Ph+) or BCR::ABL1-like (Ph-like) acute lymphoblastic leukemia (ALL)
Product: HYDROCORTISONE, PREDNISOLONE ACETATE PH. EUR., ASCIMINIB HYDROCHLORIDE, CYTARABINE, DEXAMETHASONE, BLINATUMOMAB, Asciminib, METHOTREXATE, DBL methotrexate injection, VINCRISTINE SULFATE, DEXAMETHASONE SODIUM PHOSPHATE

Primary endpoint: Part 1 Dose Escalation: Incidence of DLTs occurring during cycle 1 (debulking induction), Part 1 Dose Escalation: incidence of severity of AEs and laboratory safety findings, Part 2 Dose Expansion: Proportion of CR evaluable participants who achieve CR treated at the RP2D at the end of cycle 1 (debulking induction)
Endpoint(s): • Proportion of participants who had a CR at the end of cycle 2 and cycle 3, • Proportion of participants who had CR and/or CRi at and by the end of: cycle 1, cycle 2, and cycle 3, • Next generation sequencing MRD negative rate at and by the end of: end of cycle 1, cycle 2, and cycle 3., • MFC MRD negative CR/CRi rate at and by the end of: cycle 1, cycle 2, and cycle 3., • Disease Free Survival, • Overall survival, Type, frequency, severity of treatment emergent adverse events, changes in laboratory parameters, ECG, and other safety data., PK parameters of asciminib at steady state: AUClast, Cmax, Tmax, Ctrough over time (sparse PK sampling)

Source: https://euclinicaltrials.eu/ctis-public/view/2025-522019-40-00